EU clinical trial 2023-510210-68-00: An open-label, long-term, safety and tolerability study of SAR445088 in participants with cold agglutinin disease previously treated with SAR445088 or never treated with SAR445088
Protocol code: LTS16637
Sponsor: Bioverativ USA Inc. (Pharmaceutical company). Phase: Human Pharmacology (Phase I)- Other. Countries: Germany (ended), Netherlands (ended), Italy (ended).
Therapeutic area(s): Diseases [C] - Hemic and Lymphatic Diseases [C15]
Gender: Female, Male. Age: 18-64 years, 65+ years. Enrolment: 13.
Status: Ended. Start date (EU): 2021-05-26. End date (EU): 2025-02-25. End date: 2025-03-04. Decision date: 2024-02-22. Results received: Yes. Last updated: 2025-03-04.
Decision dates by country: NL: 2024-02-22, DE: 2024-02-23, IT: 2024-02-26

Condition(s): Autoimmune haemolytic anaemia
Product: riliprubart

Primary endpoint: Number of participants with treatment-emergent adverse events (TEAE)
Endpoint(s): Mean change from baseline in total bilirubin over time, Mean change from baseline in hemoglobin over time, Mean change from baseline in lactate dehydrogenase over time, Mean change from baseline in reticulocyte count over time, Complement System Classical Pathway Levels as Measured by WIESLAB Assay, Complement System Alternative Pathway Levels as Measured by WIESLAB Assay, Mean change in CH50 over time, Total Complement Factor C4 Levels, PK parameter: Cmax, PK Parameter: AUC, Number of participants with anti-SAR445088 antibodies

Source: https://euclinicaltrials.eu/ctis-public/view/2023-510210-68-00